EU clinical trial 2024-515928-36-00: VASCULAR AND RENAL IMPACT OF ENDOTHELIN-1 RECEPTOR BLOCKADE IN PATIENTS WITH UNCONTROLLED ARTERIAL HYPERTENSION - ENDOTHELIN-2
Protocol code: 2018/0350/HP
Sponsor: Centre Hospitalier Universitaire Rouen (Hospital/Clinic/Other health care facility). Phase: Therapeutic exploratory (Phase II). Countries: France (ended).
Therapeutic area(s): Analytical, Diagnostic and Therapeutic Techniques and Equipment [E] - Diagnosis [E01]
Gender: Female, Male. Age: 18-64 years, 65+ years. Enrolment: 24.
Status: Ended. Start date (EU): 2024-08-20. End date (EU): 2026-04-20. Decision date: 2024-08-19. Results received: No. Last updated: 2026-06-16.

Condition(s): Uncontrolled arterial hypertension
Product: BOSENTAN VIATRIS 125 mg, comprimé pelliculé, BOSENTAN VIATRIS 62,5 mg, comprimé pelliculé, Cellulose microcristalline

Primary endpoint: 8-week change in amplitude of endothelium-dependent radial artery dilatation with sustained increase in blood flow
Endpoint(s): 8 week change in peripheral and central arterial pressures and arterial stiffness, 8-week change in local concentrations of NO, EETs and ET-1 with sustained increase in blood flow, Variation in 8 weeks of natriuresis and measured glomerular filtration rate (DTPA labeled by the technetium 99m)

Source: https://euclinicaltrials.eu/ctis-public/view/2024-515928-36-00